EU clinical trial 2023-503523-25-00: A Randomized Study of Two Dosing Regimens of Adagrasib in Patients with Previously Treated Non-Small Cell Lung Cancer with KRAS G12C Mutation
Protocol code: 849-021
Sponsor: Mirati Therapeutics Inc. (Pharmaceutical company). Phase: Therapeutic exploratory (Phase II). Countries: France (ongoing, recruitment ended), Hungary (ended), Spain (ongoing, recruitment ended), Croatia (ended), Greece (ongoing, recruitment ended), Poland (ended), Italy (ongoing, recruitment ended), Romania (ended), Netherlands (ongoing, recruitment ended).
Therapeutic area(s): Diseases [C] - Neoplasms [C04]
Gender: Female, Male. Age: 18-64 years, 65+ years. Enrolment: 267.
Start date (EU): 2024-02-29. Decision date: 2023-12-15. Results received: No. Last updated: 2026-07-24.
Decision dates by country: HU: 2024-01-31, PL: 2024-06-14, FR: 2023-12-15, HR: 2024-04-26, IT: 2024-06-17, GR: 2024-05-08, ES: 2024-01-29, RO: 2024-06-17, NL: 2024-06-21

Condition(s): Non-small cell lung cancer
Product: Adagrasib

Primary endpoint: Objective Response Rate (ORR) using Response Evaluation Criteria in Solid Tumors version 1.1 (RECIST 1.1) per BICR.
Endpoint(s): Safety characterized by type, incidence, severity, timing, seriousness and relationship to study treatment of AEs, laboratory abnormalities, and number of patients modifying or discontinuing study treatment due to an AE., Secondary efficacy endpoints: Overall Survival (OS), Progression-Free Survival (PFS) per BICR, Duration of Response (DOR) per BICR., Summary statistics of adagrasib plasma concentrations., Patient-Reported Outcome (PRO) scores using PRO-CTCAE and EQ-5D-5L.

Source: https://euclinicaltrials.eu/ctis-public/view/2023-503523-25-00